EU clinical trial 2024-520422-11-00: Effect of preoperative intramasseteric methylprednisolone injection on the post-operative sequelae of lower third molar surgery: a placebo controlled, randomized, double-blinded study
Sponsor: Semmelweis University (Educational Institution). Phase: Therapeutic use (Phase IV). Countries: Hungary (authorised, recruitment pending).
Therapeutic area(s): Analytical, Diagnostic and Therapeutic Techniques and Equipment [E] - Dentistry [E06]; Analytical,Diagnostic,Therapeutic Techniques and Equipment [E]-Surgical Procedures, Operative [E04]
Gender: Female, Male. Age: 18-64 years. Enrolment: 30.
Status: Authorised, recruitment pending. Decision date: 2025-01-15. Results received: No. Last updated: 2025-01-15.

Condition(s): postoperative sequalae
Product: SOLU-MEDROL 40 mg/1 mL, poudre et solvant pour solution injectable

Source: https://euclinicaltrials.eu/ctis-public/view/2024-520422-11-00